EU clinical trial 2023-507557-16-00: An open label, multi-center asciminib roll-over study to assess long-term safety in patients who have completed a Novartis sponsored asciminib study and are judged by the investigator to benefit from continued treatment
Protocol code: CABL001A2001B
Sponsor: Novartis Pharma AG (Pharmaceutical company). Phase: Therapeutic confirmatory (Phase III). Countries: Czechia (ongoing, recruiting), Germany (ongoing, recruiting), Portugal (ongoing, recruiting), Spain (ongoing, recruiting), Poland (ongoing, recruiting), Denmark (ended), Bulgaria (ongoing, recruiting), Austria (ongoing, recruiting), Romania (ongoing, recruiting), France (ongoing, recruiting), Italy (ongoing, recruiting), Greece (authorised, recruitment pending), Hungary (authorised, recruitment pending), Slovakia (authorised, recruitment pending).
Therapeutic area(s): Diseases [C] - Neoplasms [C04]
Gender: Female, Male. Age: 18-64 years, 65+ years. Enrolment: 260.
Start date (EU): 2022-08-31. Decision date: 2024-03-06. Results received: No. Last updated: 2026-01-15.
Decision dates by country: ES: 2024-03-07, PL: 2024-03-25, PT: 2024-03-06, DK: 2024-03-07, AT: 2024-05-02, GR: 2025-03-07, HU: 2025-03-13, SK: 2025-03-20, CZ: 2024-03-08, IT: 2024-03-11, RO: 2024-03-12, DE: 2024-03-07, FR: 2024-03-07, BG: 2024-04-15

Condition(s): chronic myelogenous leukemia (CML) or Philadelphia Chromosome positive acute lymphoblastic leukemia (Ph+ ALL)
Product: Tasigna 200 mg hard capsules, DASATINIB, IMATINIB, DASATINIB, ASCIMINIB HYDROCHLORIDE, NILOTINIB, IMATINIB, DASATINIB, NILOTINIB, BOSUTINIB, BOSUTINIB, Tasigna 150 mg hard capsules, DASATINIB, Tasigna 150 mg hard capsules, Tasigna 150 mg hard capsules, IMATINIB, Tasigna 150 mg hard capsules, Tasigna 200 mg hard capsules, Tasigna 200 mg hard capsules, Tasigna 200 mg hard capsules, Tasigna 150 mg hard capsules, Tasigna 200 mg hard capsules, ASCIMINIB HYDROCHLORIDE, Tasigna 200 mg hard capsules

Primary endpoint: The frequency and severity of AEs/SAEs
Endpoint(s): Proportion of participants with clinical benefit as assessed by the investigator at scheduled visits

Source: https://euclinicaltrials.eu/ctis-public/view/2023-507557-16-00